EU clinical trial 2026-526167-38-00: ALBUMINUS: Dose reduction of human albumin during large-volume paracentesis in patients with cirrhosis
Protocol code: NL-011001
Sponsor: Amsterdam UMC Stichting (Patient organisation/association). Phase: Phase III and phase IV (Integrated). Countries: Netherlands (authorised, recruitment pending).
Therapeutic area(s): Diseases [C] - Digestive System Diseases [C06]
Gender: Female, Male. Age: 18-64 years, 65+ years. Enrolment: 634.
Status: Authorised, recruitment pending. Decision date: 2026-06-23. Results received: No. Last updated: 2026-06-23.

Condition(s): liver cirrhosis
Product: Albuman 200 g/l, innrennslislyf, lausn.

Primary endpoint: The primary outcome measure will be described as the proportion of patients with at least one overt liver-related decompensation events between randomization and 52 weeks. These events include: • Spontaneous bacterial peritonitis • HRS-AKI • Variceal bleeding • Hepatic encephalopathy Each of these decompensation events are defined according to international criteria, as described in the protocol.
Endpoint(s): The incidence of new-onset AKI, defined as a 26,5 μmol rise in creatinine <48h, leading to contact with hospital and/or hospitalization, assessed per LVP., Chronic kidney disease (CKD)-stage progression, leading to contact with hospital and/or hospitalization, monitored during the evaluation moments., ≥ 25% reduction in eGFR, leading to contact with hospital and/or hospitalization assessed per LVP., Hyponatremia (< 130mmol/L), leading to contact with hospital and/or hospitalization assessed per LVP, Hemodynamic instability (mean arterial pressure < 60mmHg), leading to contact with hospital and/or hospitalization assessed per LVP., Development of fluid overload related events (pulmonary edema leading to respiratory dysfunction), leading to contact with hospital and/or hospitalization assessed per LVP., Adverse events as reported by the healthcare provider, leading to contact with hospital and/or hospitalization assessed per LVP., Quality of life, measured with the EuroQol-5 Dimensions-5 Levels questionnaire (EQ-5D-5L) monitored during the evaluation moments., Medical costs, measured with iMedical Consumption Questionnaire (iMCQ), monitored during the evaluation moments., Productivity loss, measured with iProductivity Cost Questionnaire (iPCQ), monitored during the evaluation moments., Time-to-decompensation event, monitored during the evaluation moments., Change in liver disease severity scores (Model For End-Stage Liver Disease (MELD) score, Child-Pugh score), monitored during the evaluation moments., Transjugular intrahepatic portosystemic shunt-free survival, monitored during the evaluation moments., Transplant-free survival, monitored during the evaluation moments., Overall survival, monitored during the evaluation moments.

Source: https://euclinicaltrials.eu/ctis-public/view/2026-526167-38-00